EU clinical trial 2022-502413-29-00: Multicenter Phase 2 study to evaluate the efficacy and safety of Cetuximab in combination with Encorafenib plus Binimetinib as induction treatment in BRAF V600E mutated MSS initially resectable or potentially resectable advanced colorectal cancer.
Protocol code: TTD-21-02
Sponsor: Asociacion Grupo Tratamiento De Tumores Digestivos (Patient organisation/association). Phase: Therapeutic exploratory (Phase II). Countries: Spain (ended).
Therapeutic area(s): Diseases [C] - Digestive System Diseases [C06]; Diseases [C] - Neoplasms [C04]
Gender: Female, Male. Age: 18-64 years, 65+ years. Enrolment: 70.
Status: Ended. Start date (EU): 2024-01-22. End date (EU): 2026-07-01. Decision date: 2023-10-30. Results received: No. Last updated: 2024-10-30.

Condition(s): BRAF V600E mutated and microsatellite stable (MSS) advanced colorectal cancer (aCRC) initially resectable or potentially resectable
Product: Braftovi 75 mg hard capsules, Mektovi 15 mg film-coated tablets, Erbitux 5 mg/mL solution for infusion

Primary endpoint: Radical treatment rate, defined as the number of patients radically treated for their primary tumor and/or distant metastases by surgery and/or by any other radical therapeutic procedure with curative intent (i.e. radiofrequency, cryotherapy, laserhyperthermia, stereotactic body radiotherapy or chemoembolization)., In case of patients undergoing surgery, the proportion of patients achieving R0 (microscopically margin-negative resection) or R1 (microscopic residual margin affected) will be assessed. For the rest of procedures, the achievement of complete tumor removal/destruction will be considered., The eligibility of each individual patient for radical treatment will be evaluated at 12 or 24 weeks after the first dose of study treatment by the MTB. If a patient is eligible, radical treatment will be performed al least 2 weeks after the end of EBC treatment and at the lasest, 10 weeks after the lastest CT evaluation.
Endpoint(s): Overall response rate (ORR), defined as the number of patients achieving complete response (CR) or partial response (PR) as best response according to the Response Evaluation Criteria in Solid Tumors (RECIST) v1.1, divided by the total number of patients., Tumor regression grade (TRG), after any surgical treatment of the primary tumor and/or distant metastases defined as five histological categories as follows: TRG1, no residual tumor; TRG2, microscopic residual tumor; TRG3, moderate response; TRG4, minor response; and TRG5, no response., Progression-free-survival (PFS), defined as the time in months from first dose of study treatment to disease progression or death (due to any cause). Patients lost to follow-up progression free and alive at the end of the study, will be censored, in K-M analysis, at the date last known to be alive and progression free., Overall survival (OS), defined as the time in months from first dose of study treatment to death due to any cause. Patients lost to follow-up or alive at the end of the study, will be censured, in K-M analysis, at the date known to be alive., Disease free survival (DFS), defined as the time in months from first dose of study treatment to cancer recurrence, second cancer, or death from any cause in resected patients. Patients lost to follow-up or disease free and alive at the end of the study, will be censores, in K-M analysis, at the date last known to be alive and disease free., Complications related to surgery and/or any other therapeutic procedure for radical treatment ocurring within 60 days after surgery (i.e. perioperative mortality, transfusions, hemorrhage, infections, wound healing, general or local complications). Incidence and severity of adverse events (AEs) graded according to the NCI CTCAE v4.03 and changes in clinical laboratory parameters and vital signs.

Source: https://euclinicaltrials.eu/ctis-public/view/2022-502413-29-00